EU clinical trial 2023-504275-24-01: Randomized clinical trial, controlled with conventional treatment to evaluate the efficacy of Plasma Rich in Growth Factors (PRGF) in the treatment of foot ulcers in diabetic patients
Protocol code: BTIIMD-01-EC-23-PIED
Sponsor: Biotechnology Institue I Mas D S.L. (Pharmaceutical company). Phase: Therapeutic use (Phase IV). Countries: Spain (ongoing, recruiting).
Therapeutic area(s): Diseases [C] - Skin and Connective Tissue Diseases [C17]; Diseases [C] - Nutritional and Metabolic Diseases [C18]
Gender: Female, Male. Age: 18-64 years, 65+ years. Enrolment: 38.
Status: Ongoing, recruiting. Start date (EU): 2024-10-24. Decision date: 2024-05-24. Results received: No. Last updated: 2025-09-11.

Condition(s): Foot ulcers in diabetic patients with peripheral arterial disease
Product: Plasma rich in growth factors

Primary endpoint: Assessment of ulcer healing evaluated with the RESVECH 2.0 index at six months
Endpoint(s): - Age - Sex - Toxic habits (tobacco, alcohol) - Body mass index, - Time of evolution - Etiology (Type of diabetes) - Ulcer dimensions (area and depth) - Previous treatments, - Change in ulcer size at three and six months (%) (area and depth) - Frequency of ulcers with complete closure at three and six months (%) - Assessment of ulcer healing assessed with the RESVECH 2.0 index at baseline and at three months, - Assessment of the severity of the ulcer as measured by the SINBAD scale at baseline, 3 and 6 months. -Assessment of pain and quality of life at baseline, three and six months using the EQ-5D-5L scale - Cost of wound closure, - Incidence and type of adverse events - Presence of infection according to SINBAD criterion 4 at baseline, three and six months - Frequency and type of deficiencies of the medical devices used for PRGF preparation, - Biomarkers involved in tissue damage repair

Source: https://euclinicaltrials.eu/ctis-public/view/2023-504275-24-01